EU clinical trial 2023-506278-10-00: "A PHASE 3, MULTICENTER, MULTINATIONAL, OPEN-LABEL EXTENSION STUDY TO EVALUATE THE LONG-TERM SAFETY OF CC-93538 IN ADULT AND ADOLESCENT SUBJECTS WITH EOSINOPHILIC ESOPHAGITIS"
Protocol code: CC-93538-EE-002
Sponsor: Celgene International II S.a.r.l. (Pharmaceutical company). Phase: Therapeutic confirmatory (Phase III). Countries: Italy (ended), Germany (ended), Austria (ended), Portugal (ended), Belgium (ended), Spain (ended), Poland (ended).
Therapeutic area(s): Phenomena and Processes [G] - Digestive System and Oral Physiological Phenomena [G10]
Gender: Female, Male. Age: 0-17 years, 18-64 years, 65+ years. Enrolment: 54.
Status: Ended. Start date (EU): 2022-04-22. End date (EU): 2025-08-11. End date: 2025-08-14. Decision date: 2024-04-18. Results received: Yes. Last updated: 2025-08-25.
Decision dates by country: DE: 2024-04-23, AT: 2024-04-23, BE: 2024-04-22, IT: 2024-04-22, PL: 2024-04-22, ES: 2024-04-22, PT: 2024-04-18

Condition(s): Eosinophilic esophagitis
Product: Cendakimab

Primary endpoint: Safety and tolerability of long-term treatment with CC-93538 evaluated by the incidence, severity, and relationship to CC-93538 of adverse events (AEs), serious adverse events (SAEs), clinical laboratory abnormalities, changes in vital signs, and physical examination abnormalities.
Endpoint(s): Immunogenicity of CC-93538 assessed through the incidence of anti-drug antibodies to CC-93538 including neutralizing antibodies when warranted.

Source: https://euclinicaltrials.eu/ctis-public/view/2023-506278-10-00